EU clinical trial 2024-515787-31-00: OPTPEMBRO : OPTimizing adjuvant prescription of PEMBROlizumab in patients with early-stage triple-negative breast cancer achieving pathologic complete response after standard neoadjuvant chemotherapy and pembrolizumab
Protocol code: UC-BCG-2401
Sponsor: Unicancer (Hospital/Clinic/Other health care facility). Phase: Therapeutic confirmatory (Phase III). Countries: France (ongoing, recruiting), Belgium (ongoing, recruiting).
Therapeutic area(s): Diseases [C] - Neoplasms [C04]
Gender: Female, Male. Age: 18-64 years, 65+ years. Enrolment: 1000.
Status: Ongoing, recruiting. Start date (EU): 2025-07-18. Decision date: 2025-03-20. Results received: No. Last updated: 2025-06-21.
Decision dates by country: BE: 2025-03-20, FR: 2025-03-20

Condition(s): Patient with early triple-negative breast cancer (TNBC) achieving pathologic complete response (pCR) after neoadjuvant systemic chemotherapy and pembrolizumab.
Product: PEMBROLIZUMAB

Primary endpoint: Recurrence-free survival is defined as the time from randomisation to invasive loco-regional or distant recurrence or death from any cause, whichever occurs first. Patients who are alive at the time of analysis without documented breast cancer recurrence will be censored at the time of their last disease evaluation.
Endpoint(s): Safety and tolerability : Grade ≥2 AEs (graded according to CTCAE version 5.0) with a focus on Grade ≥2 immune-related adverse events, Safety and tolerability : PRO CTCAE composite score of selected events (bloating, diarrhea, abdominal pain, rash, itching, anorexia, nausea, fatigue, dyspnea, radiation skin reaction, myalgia, arthralgia, pain, and peripheral sensory neuropathy), Health-related quality-of-life (QoL) and emotional distress : Overall QoL measured by the summary score of the EORTC QLQ-C30 questionnaire, Health-related quality-of-life (QoL) and emotional distress : & 1.2.3 Individual scores of all domains of the EORTC QLQ-30, EORTC-BR42 and EQ5D5L questionnaires, Health-related quality-of-life (QoL) and emotional distress : Fear of recurrence will be measured by item 11 of the Impact of Cancer (IOC) questionnaire, Fertility and Reproductive Toxicity : Menstruation recovery rate, Fertility and Reproductive Toxicity : Rate and outcome of pregnancy, Fertility and Reproductive Toxicity : Patterns of use of LHRH agonist during adjuvant pembrolizumab treatment, Efficacy : Invasive breast cancer-free survival (IBCFS) is defined as the time from randomisation to invasive ipsilateral or contra-lateral breast tumour recurrence, loco-regional invasive recurrence, distant recurrence, and death from breast cancer, death from non-breast cancer or from an unknown cause. Patients alive with no evidence of an IBCFS event at the time of their last visit will be censored at the time of the last examination., Efficacy : Distant relapse free-survival (DRFS) is defined as the time from randomisation to distant recurrence, death from non-breast cancer or from an unknown cause. Patients alive with no evidence of a DRFS event at the time of their last visit will be censored at the time of the last examination., Efficacy : Incidence of second primary cancer, in a competing risk model with deaths. Patients alive with no evidence of second cancer at the time of their last visit will be censored at the time of the last examination., Efficacy : Overall survival is defined as the time from randomisation to death. Patients known to be still alive or lost to follow-up will be censored., Hierarchical composite outcome : Hierarchical outcome of deaths, distant recurrence, local recurrence, Grade 3-4 irAEs, Grade 2 irAEs, overall quality of life (summary score of EORTC QLQ-C30)., Economic evaluation : Patient-level life-time incremental cost per QALY; probability of cost-effectiveness Country-level total budget impact for a real-world population

Source: https://euclinicaltrials.eu/ctis-public/view/2024-515787-31-00